EU clinical trial 2024-516064-28-00: A Phase 3, Randomized, Double-Blind, Placebo-Controlled Multicenter Study of Itolizumab in Combination with Corticosteroids for the Initial Treatment of Acute Graft Versus Host Disease
Protocol code: EQ-100-02
Sponsor: Equillium Inc. (Pharmaceutical company). Phase: Therapeutic confirmatory (Phase III). Countries: Spain (ended), Portugal (ended), France (ended), Germany (ended), Belgium (ended), Italy (ended).
Therapeutic area(s): Phenomena and Processes [G] - Immune system processes [G12]
Gender: Female, Male. Age: 0-17 years, 18-64 years, 65+ years. Enrolment: 99.
Status: Ended. Start date (EU): 2022-09-27. End date (EU): 2025-05-12. Decision date: 2024-08-20. Results received: No. Last updated: 2025-03-27.
Decision dates by country: BE: 2024-08-20, FR: 2024-09-02, DE: 2024-08-26, PT: 2024-08-28, ES: 2024-08-21, IT: 2024-10-07

Condition(s): Acute Graft Versus Host Disease
Product: itolizumab-matching placebo, EQ001

Primary endpoint: Complete Response rate at Day 29.
Endpoint(s): 1. Overall response rate at Day 29., 2. Durable complete response rate from Day 29 through Day 99.

Source: https://euclinicaltrials.eu/ctis-public/view/2024-516064-28-00